EU clinical trial 2024-520364-34-00: Effects of ziltivekimab versus placebo on coronary atherosclerosis in patients with acute myocardial infarction. A serial, multivessel, intravascular ultrasound, near-infrared spectroscopy and optical coherence tomography imaging study
Protocol code: NN6018-8195
Sponsor: Novo Nordisk A/S, ECRI-trials B.V. (Pharmaceutical company, Patient organisation/association). Phase: Therapeutic confirmatory (Phase III). Countries: Italy (ongoing, recruiting), Netherlands (authorised, recruiting), Austria (ongoing, recruiting), Denmark (ongoing, recruiting), Spain (ongoing, recruiting).
Therapeutic area(s): Diseases [C] - Cardiovascular Diseases [C14]
Gender: Female, Male. Age: 18-64 years, 65+ years. Enrolment: 249.
Start date (EU): 2026-02-23. Decision date: 2025-10-13. Results received: No. Last updated: 2026-08-07.
Decision dates by country: AT: 2025-10-20, ES: 2025-10-20, NL: 2025-10-20, DK: 2025-10-13, IT: 2025-10-15

Condition(s): Acute myocardial infarction
Product: Placebo (ziltivekimab), ziltivekimab

Primary endpoint: Change in percent atheroma volume (PAV) as determined by greyscale IVUS in matched regions of interest. Measured from randomisation to end-of-study.
Endpoint(s): Change in maximum lipid core burden index (LCBI) in any 4-mm segment (maxLCBI4mm) as determined by NIRS in matched regions of interest. Measured from randomisation to end-of-study., Change in minimal fibrous cap thickness as determined by OCT in matched regions of interest. Measured from randomisation to end-of-study., Change in LCBI total as determined by NIRS in matched regions of interest. Measured from randomisation to end-of-study., Change in average angular extension (AAE) of macrophages as determined by OCT in matched regions of interest. Change in LCBI total as determined by NIRS in matched regions of interest. Measured from randomisation to end-of-study., Change in normalized total atheroma volume (NTAV) by IVUS in matched regions of interest. Measured from randomisation to end-of-study., Change in mean fibrous cap thickness as determined by OCT in matched regions of interest. Measured from randomisation to end-of-study., Change in IL-6. Measured from randomisation to week 4 and week 52., Change in hs-CRP. Measured from randomisation to to week 4 and week 52., Change in hs-TnT . Measured from randomisation to week 4 and week 52., Change in NT-pro-BNP . Measured from randomisation to week 4 and week 52., Change in lipid and inflammatory markers. Measured from randomisation to week 4 and week 52., Time to first occurrence of: All-cause death Cardiac death Non-fatal spontaneous myocardial infarction Any coronary revascularizationa Non-fatal stroke Transient ischemic attack Measured from randomisation to end-of-study.

Source: https://euclinicaltrials.eu/ctis-public/view/2024-520364-34-00